EU clinical trial 2025-522841-23-00: ALaDIN - Use of low doses of interleukin-2 in autism spectrum disorders
Protocol code: APHP230867
Sponsor: Assistance Publique Hopitaux De Paris (Hospital/Clinic/Other health care facility). Phase: Therapeutic exploratory (Phase II). Countries: France (authorised, recruitment pending).
Therapeutic area(s): Psychiatry and Psychology [F] - Mental Disorders [F03]
Gender: Female, Male. Age: 0-17 years. Enrolment: 22.
Status: Authorised, recruitment pending. Decision date: 2025-11-17. Results received: No. Last updated: 2026-05-06.

Condition(s): Autism Spectrum disorder ASD
Product: ILT-101 liquide, Placebo of ILT-101

Primary endpoint: Change in Tregs (in % of CD4+ cells and absolute value) between baseline and D8, compared with ILT-101 and placebo.
Endpoint(s): Clinical:, Socio-adaptive symptoms : Vineland II Adaptive Behavior Composite- Total Score [at D0, D85, D169 and D275]., Social Cognition: Vineland II Adaptive Behavior Composite- Score Socialization Domain [at D0, D85, D169 and D275]., Communication: Vineland II Adaptive Behavior Composite - Communication Domain Score [at D0, D85, D169 and D275]., Global functional impact: Vineland Adaptive Behavior Composite - Daily Life Domain Score [at D0, D85, D169 and D275]., Social Communication: Brief Observation of Social - Communication Change (BOSCC) [at D0, D85, D169 and D275] Social Cognition, Social cognition: Social Responsiveness Scale - total score [at D0, D85, D169 and D275]., Social cognition: Autism Diagnostic observation schedule-2 [at D0, 169 and D275]., Repetitive behaviour and stereotypies: Aberrant Behavior Checklist [at D0, D85, D169 and D275]., Hyperactivity: ADHD Rating Scale parent report- total score [at D0, 85, 169 and D275]., Global functional impact: Clinical Global Improvement - [at D0, D85, D169 and D275]., Global functional impact: Caregiver Strain Index - [at D0, D85, D169 and D275], Biological:, Treg, Th17 and CD25 assays (in % of CD4+ and absolute value) [at D0, D8, D29, D85, 169 and D275], and AUC (D0-D29 / D29-169), Tolerance:, Pediatric adverse event rating scale [at D0, D8, D85, D169]

Source: https://euclinicaltrials.eu/ctis-public/view/2025-522841-23-00